EU clinical trial 2023-510282-10-00: A PHASE 1B DOSE RANGE FINDING STUDY OF PHENSERINE COMPARED TO DONEPEZIL IN PARTICIPANTS WITH EARLY OR MILD ALZHEIMER’S DISEASE
Sponsor: Helse Stavanger HF (Hospital/Clinic/Other health care facility). Phase: Human Pharmacology (Phase I)- Other. Countries: Norway (ended).
Therapeutic area(s): Diseases [C] - Nervous System Diseases [C10]
Gender: Female, Male. Age: 18-64 years, 65+ years. Enrolment: 16.
Status: Ended. Start date (EU): 2025-02-11. End date (EU): 2025-12-08. Decision date: 2024-12-18. Results received: No. Last updated: 2024-12-18.

Condition(s): Mild Cognitive Impairment, Alzheimer's disease
Product: ARICEPT 10 mg film coated tablets, ARICEPT 5 mg film coated tablets, Phenserine tartrate, Phenserine tartrate

Primary endpoint: Changes in exosome biomarkers of pre-programmed cell death, synaptic integrity and function, neuroinflammation, and AD-related protein trafficking in participants treated with phenserine versus those treated with donepezil.
Endpoint(s): Safety and tolerability of phenserine compared to donepezil in participants with early or mild AD based on the frequencies of reported or observed adverse events (AEs) and serious adverse events (SAE), vital signs, clinical laboratory evaluations, ECGs, modified CSSRS scores., Pharmacokinetic parameters will be assessed at steady state for determination of dose-response relationships for phenserine and donepezil, Proportion of participants in the phenserine arm achieving the target cholinesterase inhibition of ~45%, stratified by dosing regimen and the time to reach the target inhibition and the duration of maintaining this target will be assessed and recorded, Compliance will be recorded, including the proportion of participants complying with the treatment schedule. Compliance is defined as drug intake within 80-120% of the scheduled dosing., Assess changes in Alzheimer's Disease (AD) biomarkers in cerebrospinal fluid (CSF): Aβ1-40, Aβ1-42, Tau, and p-tau, and in blood plasma: p-tau217 and Nfl., Neuropsychology assessments will be conducted using the FLAME computer-based domain composites for memory, executive function, attention and sustained attention to evaluate changes over the 8-week treatment period in the phenserine treated participants compared to those who received donepezil., The Montreal Cognitive Assessment (MoCA) will be administered at baseline and at the end of the study to evaluate changes in overall cognitive function across multiple domains, including visuospatial abilities, language, attention, memory, and executive function.

Source: https://euclinicaltrials.eu/ctis-public/view/2023-510282-10-00